EU clinical trial 2023-503362-24-01: 68Ga satoreotide trizoxetan PET/CT in patients with high grade neuroendocrine lung cancer
Sponsor: Rigshospitalet (Hospital/Clinic/Other health care facility). Phase: Therapeutic exploratory (Phase II). Countries: Denmark (ended).
Therapeutic area(s): Analytical, Diagnostic and Therapeutic Techniques and Equipment [E] - Diagnosis [E01]; Analytical, Diagnostic and Therapeutic Techniques and Equipment [E] - Investigative Techniques [E05]; Diseases [C] - Neoplasms [C04]
Gender: Female, Male. Age: 18-64 years, 65+ years. Enrolment: 20.
Status: Ended. Start date (EU): 2023-08-09. End date (EU): 2025-06-23. Decision date: 2023-05-10. Results received: Yes. Last updated: 2023-05-10.

Condition(s): large cell neuroendocrine lung cancer, small cell lung cancer

Primary endpoint: The fraction of patients with SCLC and LCNEC who have at least one malignant lesion that can be identified with 68Ga-satoreotide trizoxetan-PET
Endpoint(s): Number and location of lesions that have been identified by 68Ga-satoreotide trizoxetan-PET in each patient will be compared with the number and location of known malignant lesions (identified by previous CT-scans, and if available, [18F]FDG-PET/CT) to evaluate the lesion-based diagnostic efficacy and to describe sites of disagreement., SUVmax, SUVpeak, SUVmean, and functional tumor volume delineated by 68Ga-satoreotide trizoxetan-PET will be measured in the identified malignant lesions, SUVmax and SUVpeak will be measured in background organs (e.g., lung, kidney, spleen, liver, lymph nodes, and brain)., The quantitative parameters in the malignant lesions will be divided by the corresponding 68Ga-satoreotide trizoxetan-uptake in background organs to estimate tumor-to-background ratio.

Source: https://euclinicaltrials.eu/ctis-public/view/2023-503362-24-01